EU clinical trial 2024-517204-11-00: A PROSPECTIVE, MULTICENTER, OPEN-LABEL, PHASE II STUDY TO EVALUATE EFFICACY AND SAFETY OR SELECTIVE INTERNAL RADIATION THERAPY PLUS XELOX, BEVACIZUMAB AND ATEZOLIZUMAB ( IMMUNE CHECKPOINT INHIBITOR) IN PATIENTS WITH LIVER-DOMINANT METASTATIC COLORECTAL CANCER
Protocol code: FFCD 1709 - SIRTCI
Sponsor: Fondation Franc.Cancerologie Digestive (Hospital/Clinic/Other health care facility). Phase: Therapeutic exploratory (Phase II). Countries: France (ongoing, recruiting).
Therapeutic area(s): Diseases [C] - Digestive System Diseases [C06]
Gender: Female, Male. Age: 18-64 years, 65+ years. Enrolment: 52.
Status: Ongoing, recruiting. Start date (EU): 2024-08-30. Decision date: 2024-08-30. Results received: No. Last updated: 2026-03-31.

Condition(s): microsatellite stable (MSS) colorectal cancer with liver-dominant metastasis
Product: Tecentriq 1 200 mg concentrate for solution for infusion, OXALIPLATINE HOSPIRA 5 mg/ml, solution à diluer pour perfusion, Avastin 25 mg/ml concentrate for solution for infusion., CAPECITABINE VIATRIS 500 mg, comprimé pelliculé

Primary endpoint: the main objective of this study is to evaluate the progression-free survival at 9 months (accoridng to RECIST 1.1) according to the investigator

Source: https://euclinicaltrials.eu/ctis-public/view/2024-517204-11-00